EU clinical trial 2024-516030-35-00: A Phase 3, randomized, open-label study of belantamab mafodotin administered in combination with lenalidomide and dexamethasone versus daratumumab, lenalidomide, and dexamethasone in participants with newly diagnosed multiple myeloma who are ineligible for autologous stem cell transplantation (TI-NDMM)-DREAMM-10
Protocol code: 214828
Sponsor: Glaxosmithkline Research & Development Limited (Pharmaceutical company). Phase: Therapeutic confirmatory (Phase III). Countries: Germany (ongoing, recruiting), Poland (ongoing, recruiting), Italy (ongoing, recruiting), Spain (ongoing, recruiting), Ireland (ongoing, recruiting), Greece (ongoing, recruiting), Belgium (ongoing, recruiting), Norway (ongoing, recruiting), France (ongoing, recruiting), Czechia (ended), Austria (authorised, recruiting).
Therapeutic area(s): Diseases [C] - Hemic and Lymphatic Diseases [C15]
Gender: Female, Male. Age: 18-64 years, 65+ years. Enrolment: 225.
Start date (EU): 2025-04-30. Decision date: 2025-04-22. Results received: No. Last updated: 2025-10-16.
Decision dates by country: IT: 2025-04-28, BE: 2025-04-22, GR: 2025-04-24, IE: 2025-04-25, DE: 2025-04-25, PL: 2025-04-27, NO: 2025-04-23, FR: 2025-04-25, CZ: 2025-04-23, ES: 2025-04-23, AT: 2025-04-28

Condition(s): Multiple myeloma
Product: Zelvina 5 mg hard capsules, Dexamethasone Tablets BP 2.0mg, Fortecortin® 2 mg Tabletten, Revlimid 25 mg hard capsules, Zelvina 10 mg hard capsules, Revlimid 5 mg hard capsules, Dexamethason 8 mg GALEN® Tabletten, Revlimid 10 mg hard capsules, Dexamethason 8 mg JENAPHARM®, Zelvina 25 mg hard capsules, DARZALEX 1800 mg solution for injection

Primary endpoint: PFS, defined as the time from the date of randomization to the date of first documented disease progression per IMWG criteria by IRC or death from any cause in the absence of progression, whichever occurs first, MRD negative status, defined as achieving MRD negativity at 10-5 sensitivity threshold assessed by NGS at least once during the time of confirmed CR or better response per IMWG criteria by IRC
Endpoint(s): PFS2, defined as the time from the date of randomization to the date of documented disease progression following the first subsequent antimyeloma therapy or death from any cause, whichever is earlier, OS, defined as the time from the date of randomization until the date of death due to any cause, CR+, defined as confirmed CR or sCR per IMWG criteria by IRC, VGPR+, defined as confirmed VGPR, CR, sCR per IMWG criteria by IRC, sMRD, defined as achieving MRD negative status at 10-5 sensitivity threshold assessed by NGS at least twice, a minimum of 1 year apart and with no MRD positive result in between, during the time of confirmed CR or better response per IMWG criteria by IRC, DoR, defined as the time from first documented evidence of PR or better until PD or death due to PD (among participants who achieve confirmed PR+ by IRC), TTST, defined as time from randomization until the date of start of second subsequent line of antimyeloma therapy (irrespective of PD) or death due to any cause, whichever is earlier, Incidence and severity of AEs and SAEs, Incidence of AEs leading to dose modifications or study intervention discontinuation, Incidence and severity of ocular findings on ophthalmic exam (changes in VA and corneal findings), Maximum post-baseline PRO-CTCAE score for each item attribute, Change from baseline in HRQoL as measured by EORTC QLQ-C30., Change from baseline in HRQoL as measured by EORTC QLQ-MY20 (Disease Symptoms domain), Plasma concentrations of belantamab mafodotin

Source: https://euclinicaltrials.eu/ctis-public/view/2024-516030-35-00